EU clinical trial 2024-513916-84-00: A prospective multicenter placebo-controlled trial to study the efficacy and safety of Tiotropium in preventing severe asthma exacerbations in partial and uncontrolled preschool asthma.
Protocol code: TIPP
Sponsor: Goethe University Frankfurt (Educational Institution). Phase: Therapeutic confirmatory (Phase III). Countries: Germany (ended).
Therapeutic area(s): Diseases [C] - Respiratory Tract Diseases [C08]
Gender: Female, Male. Age: 0-17 years. Enrolment: 152.
Status: Ended. Start date (EU): 2022-02-18. End date (EU): 2025-04-02. Decision date: 2024-06-05. Results received: Yes. Last updated: 2024-06-05.

Condition(s): Severe asthma exacerbations in partial and uncontrolled preschool asthma
Product: Tiotropium bromide monohydrate, Respimat® Inhaler one cartridge of Placebo

Primary endpoint: Time to first severe exacerbations, defined by hospitalization and/or at least 3 days of systemic steroids or one day of rectal prednisolone (Rectodelt®).
Endpoint(s): number of severe exacerbations, number of hospitalizations (severe exacerbation), (severe) exacerbation-free survival time, number of asthma-related events defined by use of antibiotics, percentage of night-time awakenings due to asthma symptoms as assessed by the electronic patients diary/PACD, percentage of days without asthma symptoms assessed by TIPP diary App (PACD), percentage of days and episodes of > 3 days with use of PRN salbutamol rescue medication, health utilization (number of physician visits), number of missed days in daycare, result of TRACK, CGI-C at end of treatment and potential biomarkers for treatment response, Eosinophils, IgE, specific IgE to common allergens (birch, grass, Dermatophagoides pteronyssinus, Alternaria, Cladosporium, cat, dog, hen's egg, cow's milk and peanut, Assessment of safety: Safety will be ensured by analysis of symptom scores and rescue medication use by the electronic diary, and adverse events (AEs).

Source: https://euclinicaltrials.eu/ctis-public/view/2024-513916-84-00